EU clinical trial 2024-512726-28-00: Multicentre Phase IV clinical trial to evaluate the efficacy of hyperthermic intraoperative chemotherapy (HIPEC) with Mitomycin-C after complete surgical debulking in patients with peritoneal metastases of colon cancer.
Protocol code: GECOP-MMC
Sponsor: Hospital Universitario De Fuenlabrada (Hospital/Clinic/Other health care facility). Phase: Therapeutic use (Phase IV). Countries: Spain (ongoing, recruiting).
Therapeutic area(s): Diseases [C] - Neoplasms [C04]
Gender: Female, Male. Age: 18-64 years, 65+ years. Enrolment: 216.
Status: Ongoing, recruiting. Start date (EU): 2022-02-14. Decision date: 2024-05-07. Results received: No. Last updated: 2024-12-12.

Condition(s): peritoneal metastases of colorectal cancer
Product: Mitomicina Accord 40 mg polvo para solución inyectable y para perfusión EFG

Primary endpoint: peritoneal recurrence-free survival at 1, 2 and 3 years.
Endpoint(s): Overall recurrence (ORS) at 1, 2 and 3 years., Locoregional and distant recurrence (isolated or coincident, with or without simultaneous peritoneal recurrence) at 1, 2, and 3 years., Postoperative complications using the CTCAE v5.0 90-day adverse event classification system, including those related to HIPEC., Prognostic factors for peritoneal and global recurrence: synchronous/metachronous PM, perioperative QTS, use of biological agents or immunotherapy, stratified PCI (1-10, 11-15, 16-20), postoperative complications, right/left colon, degree of differentiation, vascular/lymphatic/perineural invasion, RAS/RAF status, microsatellite instability and degree of peritoneal tumour regression., Overall survival at 1, 2 and 3 years., Study of Quality of Life in both groups using the EORTC QLQ-C30 and QLQ-CR29 questionnaires (APPENDIX IV), to be carried out at the aforementioned times., Correlation surgical PCI - pathological PCI

Source: https://euclinicaltrials.eu/ctis-public/view/2024-512726-28-00